EU clinical trial 2024-513533-20-00: A Phase 3 Extension Study to Evaluate the Long-term Safety and Efficacy of Tulisokibart in Participants With Crohn’s Disease or Ulcerative Colitis
Protocol code: MK-7240-011
Sponsor: Merck Sharp & Dohme LLC (Pharmaceutical company). Phase: Therapeutic confirmatory (Phase III). Countries: France (ongoing, recruiting), Poland (ongoing, recruiting), Hungary (ongoing, recruiting), Czechia (ongoing, recruiting).
Therapeutic area(s): Diseases [C] - Digestive System Diseases [C06]
Gender: Female, Male. Age: 18-64 years, 65+ years. Enrolment: 137.
Status: Ongoing, recruiting. Start date (EU): 2025-02-25. Decision date: 2025-01-24. Results received: No. Last updated: 2026-07-16.
Decision dates by country: PL: 2025-01-27, HU: 2025-01-27, FR: 2025-05-06, CZ: 2025-01-24

Condition(s): Crohn’s Disease or Ulcerative Colitis
Product: Placebo to MK-7240 (Tulisokibart), tulisokibart

Primary endpoint: Percentage of participants with ≥1 adverse event (AE), Percentage of participants discontinuing from study therapy due to AE
Endpoint(s): Percentage of participants achieving clinical remission per Crohn’s Disease Activity Index score at Week 364, Percentage of participants achieving 2-patient-reported outcomes (PRO-2) remission per Crohn’s Disease Activity Index score at Week 364, Percentage of participants achieving endoscopic remission per Simplified Endoscopic Score for Crohn’s Disease at Week 364, Percentage of participants with UC achieving clinical remission per Modified Mayo Score at Week 364

Source: https://euclinicaltrials.eu/ctis-public/view/2024-513533-20-00